EU clinical trial 2025-523911-13-00: A Phase 3, Randomized, Double-Blind, Placebo-Controlled Study to Evaluate the Efficacy and Safety of ALKS 2680 in Adults With Narcolepsy Type 1
Protocol code: ALKS 2680-302
Sponsor: Alkermes Inc. (Pharmaceutical company). Phase: Therapeutic confirmatory (Phase III). Countries: Italy (authorised, recruitment pending), France (authorised, recruitment pending), Netherlands (ongoing, recruiting), Spain (authorised, recruitment pending), Belgium (ongoing, recruiting).
Therapeutic area(s): Diseases [C] - Nervous System Diseases [C10]
Gender: Female, Male. Age: 18-64 years, 65+ years. Enrolment: 75.
Start date (EU): 2026-07-27. Decision date: 2026-06-02. Results received: No. Last updated: 2026-08-03.
Decision dates by country: NL: 2026-06-09, BE: 2026-06-08, ES: 2026-06-03, FR: 2026-06-03, IT: 2026-06-03

Condition(s): Narcolepsy Type 1
Product: ALKS 2680, ALKS 2680, Placebo to match ALKS 2680, Placebo to match Alks 2680/Alixorexton

Primary endpoint: Change in Epworth Sleepiness Scale from baseline to Week 12 by dose level
Endpoint(s): Change in mean sleep latency on Maintenance of Wakefulness Test from baseline to Week 12 by dose level, Weekly cataplexy rate (WCR) at Week 12 by dose level, Change in select patient-reported outcome measures from baseline to Week 12 by dose level

Source: https://euclinicaltrials.eu/ctis-public/view/2025-523911-13-00